EU clinical trial 2025-520821-19-00: Rapamycin Dose-Ranging Efficacy Study: A Phase II, proof of concept, double-blind, placebo-controlled, randomized, parallel-group, dose-response comparison of the effects of different strengths of rapamycin cream applied topically in subjects diagnosed with port wine stains
Protocol code: AFT-RAP-01
Sponsor: Aft Pharmaceuticals Limited (Pharmaceutical company). Phase: Therapeutic exploratory (Phase II). Countries: Spain (ongoing, recruiting).
Therapeutic area(s): Diseases [C] - Skin and Connective Tissue Diseases [C17]
Gender: Female, Male. Age: 0-17 years, 18-64 years. Enrolment: 30.
Status: Ongoing, recruiting. Start date (EU): 2024-01-02. Decision date: 2025-01-27. Results received: No. Last updated: 2026-03-16.

Condition(s): Subjects diagnosed with port wine stains
Product: SIROLIMUS, SIROLIMUS

Primary endpoint: The primary efficacy endpoint is the change in extent and intensity of PWS colour from baseline to week 12 (V3), or at last visit if early withdrawal/discontinuation occurs, measured using a colorimetry system through standardized clinical photographs.
Endpoint(s): Change in extent and intensity of PWS colour from baseline at weeks 0, 4, 8 and follow-up/last assessment, measured using a colorimetry system through standardized clinical photographs., Subjective improvement rating of PWS from baseline after 0, 4, 8 and 12 weeks of treatment, Clinic Objective improvement rating in PWS from baseline after 0, 4, 8 and 12 weeks of treatment, Photographic Objective improvement rating in PWS from baseline after 0, 4, 8 and 12 weeks of treatment

Source: https://euclinicaltrials.eu/ctis-public/view/2025-520821-19-00